EU clinical trial 2024-516511-24-00: A Patient guided dose reduction strategy of tyrosine kinase inhibitors in chronic myeloid leukaemia: RODEO study
Sponsor: Stichting Radboud universitair medisch centrum (Hospital/Clinic/Other health care facility). Phase: Phase III and phase IV (Integrated). Countries: Netherlands (ended).
Therapeutic area(s): Diseases [C] - Hemic and Lymphatic Diseases [C15]
Gender: Female, Male. Age: 18-64 years, 65+ years. Enrolment: 136.
Status: Ended. Start date (EU): 2024-11-14. End date (EU): 2025-08-11. Decision date: 2024-09-26. Results received: No. Last updated: 2024-11-14.

Condition(s): Chronic myeloid leukaemia
Product: IMATINIB, PONATINIB, BOSUTINIB, NILOTINIB, DASATINIB

Primary endpoint: The primary study outcome is the proportion of patients with treatment failure at 12 months after first dose reduction.

Source: https://euclinicaltrials.eu/ctis-public/view/2024-516511-24-00